EU clinical trial 2025-520813-29-00: A study in healthy people to test how empagliflozin is taken up in the body when taken as a whole tablet or dissolved in water and mixed with food
Protocol code: 1245-0358
Sponsor: Boehringer Ingelheim International GmbH (Pharmaceutical company). Phase: Human Pharmacology (Phase I)- Other. Countries: Germany (ended).
Therapeutic area(s): Not possible to specify
Gender: Female, Male. Age: 18-64 years. Enrolment: 14.
Status: Ended. Start date (EU): 2025-05-21. End date (EU): 2025-09-12. Decision date: 2025-04-03. Results received: No. Last updated: 2025-04-03.

Condition(s): Healthy volunteer trial

Source: https://euclinicaltrials.eu/ctis-public/view/2025-520813-29-00